EU clinical trial 2024-510919-29-00: An Operationally Seamless, Randomized Phase 2/3 Study Consisting of a Phase 2 Single Blind, Dose-Evaluation Phase and a Phase 3 Double-Blind, Placebo-controlled Phase to Assess the Efficacy and Safety of Setrusumab in Subjects with Osteogenesis Imperfecta
Protocol code: UX143-CL301
Sponsor: Ultragenyx Pharmaceutical Inc. (Pharmaceutical company). Phase: Phase II and Phase III (Integrated). Countries: Poland (ongoing, recruitment ended), Portugal (ongoing, recruitment ended), Netherlands (ongoing, recruitment ended), Italy (ongoing, recruitment ended), France (ongoing, recruitment ended), Germany (ongoing, recruitment ended).
Therapeutic area(s): Diseases [C] - Musculoskeletal Diseases [C05]
Gender: Female, Male. Age: 0-17 years, 18-64 years. Enrolment: 53.
Status: Ongoing, recruitment ended. Start date (EU): 2023-05-08. Decision date: 2024-05-31. Results received: No. Last updated: 2026-06-09.
Decision dates by country: NL: 2024-05-31, PL: 2024-06-03, PT: 2024-05-31, DE: 2024-06-19, IT: 2024-06-10, FR: 2024-05-31

Condition(s): Osteogenesis imperfecta (OI)
Product: Dextrose / glucose 5% solution in water, Setrusumab

Primary endpoint: Phase II: Percent change in serum P1NP from Baseline at Month 1, Phase III: Annualized rate of all radiographically-confirmed fractures, excluding morphometric vertebral fractures and fractures of the fingers, toes, face, and skull, at the primary analysis
Endpoint(s): Phase II: Serum setrusumab concentration at scheduled time points, Phase II - Baseline-corrected AUEC for serum P1NP over a 1- and 2-month timeframe, Phase II - Percent change from Baseline in bone turnover markers (P1NP and OCN) over time, Phase II - Change from Baseline in DXA lumbar spine BMD z-scores over time, Phase II - Percent change from Baseline in DXA lumbar spine BMD over time, Phase II - Frequency, severity, and relationship to treatment of TEAEs, SAEs, AESIs, Phase II - Incidence of anti-setrusumab binding and neutralizing antibodies at scheduled time points, Key Secondary Endpoints: Phase III - Annualized rate of all radiographically-confirmed fractures, excluding morphometric vertebral fractures, but including fractures of the fingers, toes, face and skull, at the primary analysis, Key Secondary Endpoints: Phase III - Annualized rate of all radiographically-confirmed fractures at the primary analysis, Key Secondary Endpoints: Phase III - Change from Baseline in DXA lumbar spine BMD z-score at the primary analysis, Phase III - Change from Baseline at the primary analysis for: • POSNA-PODCI Sports/Physical Functioning and Pain/comfort subscale scores for subjects < 18 years of age at screening • SF-36 PF and BP Domain Scales for subjects ≥ 18 years of age at screening, Phase III - Frequency, severity, and relationship to treatment of TEAEs, SAEs, and AESIs, Phase III - Incidence of binding and neutralizing anti-setrusumab antibodies at scheduled time points, Key Secondary Endpoints: Phase III - Proportion of subjects experiencing new radiographically confirmed fractures, excluding morphometric vertebral fractures and fractures of the fingers, toes, face, and skull at the primary analysis

Source: https://euclinicaltrials.eu/ctis-public/view/2024-510919-29-00